EU clinical trial 2025-523222-40-00: An Open-Label Phase IIa Trial Exploring the Safety, Tolerability, and Efficacy of the T Cell Engager OM336 for Desensitization of Kidney Transplant Candidates
Sponsor: Medical University Of Vienna (Educational Institution). Phase: Therapeutic exploratory (Phase II). Countries: Austria (authorised, recruitment pending).
Therapeutic area(s): Diseases [C] - Pathological Conditions, Signs and Symptoms [C23]
Gender: Female, Male. Age: 18-64 years, 65+ years. Enrolment: 6.
Status: Authorised, recruitment pending. Decision date: 2026-07-31. Results received: No. Last updated: 2026-07-31.

Condition(s): End stage renal failure
Product: PARACETAMOL, VALACICLOVIR, DEXAMETHASONE, DIPHENHYDRAMINE, OM336

Primary endpoint: Assessment of the safety and tolerability of OM336 through week 24., Co-Primary endpoint: Assessment of vPRA levels at week 24.
Endpoint(s): Safety and tolerability through month 24, and in the event of transplantation, safety over at least 12 months post-transplantation., vPRA at 3, 12, 15, 18, 21, and 24 months., Donor frequency according to ET Donor calculator at 3, 6, 12, 15, 18, 21, and 24 months., Number of unacceptable antigens that can be delisted at 3, 6, 12, 15, 18, 21, and 24 months, according to the following rules: (i) Unacceptable “plausible” antigens: if <1000 MFI; (ii) locally unacceptable antigens without recorded sensitizing event: if <10.000, provided a peri-transplant desensitization program is available (Vienna 6) or if <3000, if no such program is available (Berlin). According to the ET rules, eligibility for AM allocation will be re-evaluated by the ET central lab., For recipients of a living donor kidney transplant, the MFI of the immunodominant DSA at 3, 6, 12, 15, 18, 21, and 24 months., OM336 study drug PK, as well as assessment of anti-drug antibodies (ADA) (schedule: see also section 8.3.). PK Parameters: maximum concentration, time to maximum concentration, area under the plasma concentration-time curve. Additional parameters (half-life, clearance, volume of distribution) will be calculated, as appropriate., vPRA defined according to a SAFB threshold of >MFI 1000 at 3, 6, 12, 15, 18, 21, and 24 months., vPRA defined according to a SAFB threshold of >MFI 3000 at 3, 6, 12, 15, 18, 21, and 24 months., vPRA defined according to a SAFB threshold of >MFI 10000 at 3, 6, 12, 15, 18, 21, and 24 months., HLA antibody characteristics (MFI course, complement fixing capability) at 3, 6, 12, 15, 18, 21, and 24 months., Crossmatch course for transplant offers, with retrospective serum evaluation from the beginning of the trial in 3-monthly intervals before transplantation, Levels of IgG, IgM, IgA at 3, 6, 12, 15, 18, 21, and 24 months., Levels of free light chains at 3, 6, 12, 15, 18, 21, and 24 months., Blood group and xeno-reactive antibodies at 3, 6, 12, 15, 18, 21, and 24 months., Vaccination titers including hepatitis B., Torque Teno virus (TTV) load at 3, 6, 12, 15, 18, 21, and 24 months., Counts of peripheral blood B cell (sub)populations including number and composition of peripheral B cells measured by high sensitivity-flow (CD20+/low/CD27+ and CD27-) at 3, 6, 9, 12, 15, 18, 21, and 24 months., Counts of peripheral blood T cells and T cell (sub)populations at 3, 6, 9, 12, 15, 18, 21, and 24 months., Peripheral blood transcriptome analysis at 3, 6, 9, 12, 15, 18, and 24 months., Serum soluble BCMA (sBCMA), blood cytokines, chemokines, and markers of inflammation at 3, 6, 9, 12, 15, 18, and 24 months, Transplantation rate through Month 24., Optional exploratory endpoints for patients participating in a substudy of bone marrow analysis and lymph node analysis may include: Number and composition of bone marrow B and plasma cells by high sensitivity-flow cytometry; of lymph node (inguinal taken during Tx) B and PC at the time of transplantation by immunohistochemistry; Peripheral B cell receptor repertoire compared to bone marrow B/ plasma cell receptor repertoire.

Source: https://euclinicaltrials.eu/ctis-public/view/2025-523222-40-00